EU clinical trial 2024-518506-41-00: A Phase 1, Open-Label, Study Evaluating the Safety, Pharmacokinetics, and Clinical Effects of Intravenously Administered PT-112 Injection in Patients with Advanced Solid Tumors and Subsequent Expansion Cohorts
Protocol code: PT-112-101
Sponsor: Promontory Therapeutics Inc. (Pharmaceutical company). Phase: Phase I and Phase II (Integrated)- Other. Countries: France (ongoing, recruitment ended).
Therapeutic area(s): Diseases [C] - Neoplasms [C04]
Gender: Male. Age: 18-64 years, 65+ years. Enrolment: 40.
Status: Ongoing, recruitment ended. Start date (EU): 2020-10-05. Decision date: 2024-11-19. Results received: No. Last updated: 2026-02-16.

Condition(s): metastatic castrate resistant prostate cancer
Product: PT-112

Primary endpoint: Expansion cohort D (metastatic Castration-Resistant Prostate Cancer): Define the recommended dose and schedule for PT-112 for pivotal studies, administered either as 250 mg/m2 on Days 1 and 15 of each 28- day cycle (Arm 2) or as 360 mg/m2 on Days 1 and 15 of Cycle 1, then 250 mg/m2 on Day 15 of each subsequent 28-day cycle (Arm 3), where the primary endpoint (benefit) is defined as DCR4.
Endpoint(s): ● Disease control rate (DCR) by disease manifestation, ● Objective response rate (ORR) in patients with RECIST-measurable disease, defined as the percentage of patients achieving a confirmed PR and CR, based on tumor assessments by CT with contrast at baseline and after every 2 cycles (8±1 weeks) of treatment through the first 6 months, then every 3 cycles (12±1 weeks), evaluated using PCWG3-modified RECIST criteria;, ● The median duration of response (DOR) for soft tissue (non-bone) lesions, calculated as from the first observation of response to the first observation of disease progression using PCWG3-modified RECIST criteria;, ● Percentage of patients who are CTC nonzero at baseline and with 0 CTCs/mL in one or more post-baseline samples (i.e., CTC0);, ● Percentage of patients who have ≥ 3 CTCs at baseline and ≤ 3 CTCs in one or more post-baseline samples (i.e., CTC conversion);, ● Percentage of patients achieving PSA50 defined as ≥ 50% reduction in serum PSA from Cycle 1 Day 1 that is confirmed at the start of a subsequent cycle as defined by PCWG3 criteria;, ● Median radiographic progression-free survival (rPFS), calculated from the start of study drug to the first observation of radiographic disease progression by PCWG3 criteria;, ● Median overall survival (OS);, ● Time to PSA progression by PCWG3 criteria, calculated from the start of study drug to the first observation of PSA progression by PCWG3 criteria;, ● Change in disease-related pain, based on American Cancer Society Daily Pain Diary assessment of worst pain over the past 24 hours (11 point scale) and analgesic consumption, ● Number of treatment-related adverse events (TRAEs) as a measure of safety and tolerability;, ● Determine the pharmacokinetics of PT-112 following dosing on Days 1 and 15 of Cycle 1;, ● Assess exposure-response and exposure-safety relationships for PT-112.

Source: https://euclinicaltrials.eu/ctis-public/view/2024-518506-41-00